EU clinical trial 2022-502821-16-00: A randomized, placebo controlled, investigator and participant-blinded study, investigating safety, tolerability and efficacy of RHH646 in participants with knee osteoarthritis
Protocol code: CRHH646A12201
Sponsor: Novartis Pharma AG (Pharmaceutical company). Phase: Therapeutic exploratory (Phase II). Countries: Denmark (ended), Germany (ended), Spain (ended), Poland (ended).
Therapeutic area(s): Diseases [C] - Musculoskeletal Diseases [C05]
Gender: Female, Male. Age: 18-64 years, 65+ years. Enrolment: 63.
Status: Ended. Start date (EU): 2023-09-01. End date (EU): 2025-02-11. End date: 2025-02-24. Decision date: 2023-06-20. Results received: Yes. Last updated: 2025-01-30.
Decision dates by country: DE: 2023-06-21, PL: 2023-06-26, DK: 2023-06-20, ES: 2023-06-22

Condition(s): Knee Osteoarthritis
Product: Placebo to RHH646 25 mg hard capsules, RHH646

Primary endpoint: Change from baseline in cartilage volume in the index region of the target knee by MRI at Week 52, Adverse Events (AEs) Electrocardiograms (ECGs) Vital signs Hematology, blood chemistry, urinalysis
Endpoint(s): RHH646 plasma concentrations, Cmin,ss at Week4 and any other PK parameter as appropriate

Source: https://euclinicaltrials.eu/ctis-public/view/2022-502821-16-00